EU clinical trial 2024-511840-22-00: An Accessorised Prefilled Syringe to an Autoinjector Pharmacokinetic Bridging Study of Tozorakimab
Protocol code: D9180C00006
Sponsor: AstraZeneca AB (Pharmaceutical company). Phase: Human Pharmacology (Phase I)- Other. Countries: Germany (ended).
Therapeutic area(s): Diseases [C] - Respiratory Tract Diseases [C08]
Gender: Female, Male. Age: 18-64 years. Enrolment: 100.
Status: Ended. Start date (EU): 2025-04-22. End date (EU): 2025-11-25. End date: 2025-11-26. Decision date: 2025-04-22. Results received: No. Last updated: 2025-07-24.

Condition(s): Inflammation, Respiratory

Source: https://euclinicaltrials.eu/ctis-public/view/2024-511840-22-00